EU clinical trial 2024-512138-13-00: A PHASE 2, OPEN-LABEL, RANDOMIZED, NON-COMPARATIVE CLINICAL TRIAL OF ADP-A2M4CD8 MONOTHERAPY AND IN COMBINATION WITH NIVOLUMAB IN SUBJECTS WITH RECURRENT OVARIAN CANCERS (SURPASS-3 STUDY/ GOG-3084)
Protocol code: ADP-0055-003
Sponsor: USWM Ct LLC (Pharmaceutical company). Phase: Therapeutic exploratory (Phase II). Countries: Spain (ongoing, recruitment ended), France (ongoing, recruitment ended).
Therapeutic area(s): Diseases [C] - Neoplasms [C04]
Gender: Female. Age: 18-64 years, 65+ years. Enrolment: 28.
Status: Ongoing, recruitment ended. Start date (EU): 2023-09-27. Decision date: 2024-07-03. Results received: No. Last updated: 2026-05-27.
Decision dates by country: ES: 2024-07-03, FR: 2024-07-03

Condition(s): Recurrent ovarian cancer positive for MAGE-A4 in human leukocyte antigen (HLA)-A2+ subjects
Product: OPDIVO 10 mg/mL concentrate for solution for infusion.

Primary endpoint: The primary endpoint for efficacy is OR defined as complete response(CR) or partial response (PR) according to RECIST v1.1 by IRAC, from T-cell infusion until documented disease progression. Both CR and PR must be confirmed by repeat assessments performed no less than 4 weeks after the criteria of response are first met.
Endpoint(s): AEs, including SAEs, Incidence, severity, and duration of the adverse events of special interest (AESIs), Replication competent lentivirus (RCL), T-cell clonality and insertional oncogenesis (IO)

Source: https://euclinicaltrials.eu/ctis-public/view/2024-512138-13-00